EU clinical trial 2023-509815-10-00: Effect of Dupilumab on nasal epithelial barrier function in patients with Chronic Rhinosinusitis with nasal polyps (CRSwNP) – an exploratory pilot study
Protocol code: EpiBar
Sponsor: Medical University Of Vienna (Educational Institution). Phase: Therapeutic use (Phase IV). Countries: Austria (ended).
Therapeutic area(s): Diseases [C] - Otorhinolaryngologic Diseases [C09]
Gender: Female, Male. Age: 18-64 years, 65+ years. Enrolment: 80.
Status: Ended. Start date (EU): 2024-05-15. End date (EU): 2026-05-22. Decision date: 2024-05-06. Results received: No. Last updated: 2024-05-06.

Condition(s): Chronic rhinosinusitis with nasal polyps, Chronic rhinosinusitis without nasal polyps
Product: Dupixent 300 mg solution for injection in pre-filled syringe, Dupixent 300 mg solution for injection in pre-filled pen

Primary endpoint: Primary endpoint is the change in barrier sensitivity (Cell index) (1) at visit 1 (baseline) in stimulated versus unstimulated cells of patients suffering from CRSsNP or CRSwNP as compared to disease controls as well as in (2) CRSwNP patients at V1 and after 6 months of dupilumab treatment (V3).
Endpoint(s): Change in barrier sensitivity as described in primary endpoint in patients over time (0, 3 and 6 months), Expression levels of tight junction proteins (by mass cytometry imaging – percentage of positive cells and intensity of staining) in selected biopsies and fixed cultured primary cells in diseased patients and compared to disease controls, Cytokine levels (pg/ml) in nasal mucosal lining fluids of diseased patients and compared to disease controls, Association of barrier sensitivity and cytokine levels, Microbiome (Diversity, Shannon index) in diseased patients and compared to disease controls, Association of barrier sensitivity and microbiome composition, Transcriptome (differentially expressed genes and pathway analysis) and cytokine levels (pg/ml) in selected cultured cells derived from diseased patients and compared to disease controls, Association of experimental (change in barrier function, transcriptome, etc.) with clinical data (TPS, SNOT-22, etc.)

Source: https://euclinicaltrials.eu/ctis-public/view/2023-509815-10-00